EU clinical trial 2023-505628-67-00: A Phase 3, Open-Label Study to Evaluate Safety and Efficacy of Epcoritamab in Combination with Rituximab and Lenalidomide (R2) compared to R2 in Subjects with Relapsed or Refractory Follicular Lymphoma (EPCORE™ FL-1)
Protocol code: M20-638
Sponsor: AbbVie Deutschland GmbH & Co. KG (Pharmaceutical company). Phase: Therapeutic confirmatory (Phase III). Countries: Denmark (ongoing, recruitment ended), Hungary (ongoing, recruitment ended), Slovakia (ongoing, recruitment ended), Sweden (ongoing, recruitment ended), Austria (ongoing, recruitment ended), Greece (ongoing, recruitment ended), Spain (ongoing, recruitment ended), Netherlands (ongoing, recruitment ended), Czechia (ongoing, recruitment ended), Germany (ongoing, recruitment ended), France (ongoing, recruitment ended), Poland (ongoing, recruitment ended), Belgium (ongoing, recruitment ended), Italy (ongoing, recruitment ended).
Therapeutic area(s): Diseases [C] - Neoplasms [C04]
Gender: Female, Male. Age: 18-64 years, 65+ years. Enrolment: 280.
Status: Ongoing, recruitment ended. Start date (EU): 2022-10-28. Decision date: 2024-04-08. Results received: No. Last updated: 2026-06-17.
Decision dates by country: HU: 2024-04-12, PL: 2024-04-12, NL: 2024-04-09, GR: 2024-05-22, ES: 2024-04-09, IT: 2024-04-11, AT: 2024-04-29, DE: 2024-04-09, SK: 2024-04-08, BE: 2024-04-18, DK: 2024-04-09, SE: 2024-04-09, CZ: 2024-04-10, FR: 2024-04-10

Condition(s): Relapsed and Refractory Follicular Lymphoma
Product: Epcoritamab (GEN3013), Epcoritamab (GEN3013), Truxima 100 mg concentrate for solution for infusion, Truxima 500 mg concentrate for solution for infusion, Revlimid 5 mg hard capsules, Revlimid 20 mg hard capsules

Primary endpoint: Progression-Free Survival (PFS), Best overall response (BOR) of CR or PR, determined by Lugano criteria (Appendix F), as assessed by an Independent Review Committee (IRC)
Endpoint(s): Percentage of Participants Achieving Complete Response (CR), Overall Survival (OS), Percentage of Participants Achieving Minimal Residual Disease (MRD) Negativity, Changes from baseline in Functional Assessment of Cancer Therapy – Lymphoma (FACT-Lym)., PFS, BOR, and CR during the study, determined per Lugano criteria as assessed by investigator., Duration of response (DOR), duration of complete response (DOCR), time to progression (TTP), and CR at the end of treatment (12 cycles), time to response (TTR), time to complete response (TTCR), per Lugano criteria as assessed by an IRC and by the investigator, respectively., Event-Free Survival (EFS), defined as the duration from randomization to the date of any of the following (whichever occurs first): • Disease progression determined by Lugano criteria as assessed by the investigator • Initiation of any non-protocol-specified new anti lymphoma therapy for any reason • Death, Time to next anti-lymphoma treatment (TTNLT)., Changes from baseline in Patient-Reported Outcome Instruments (PROs; including Patient Global Impression of Severity [PGIS], Patient Global Impression of Change [PGIC], and EuroQol 5 dimension questionnaire, 5 level [EQ 5D 5L]).

Source: https://euclinicaltrials.eu/ctis-public/view/2023-505628-67-00